EU clinical trial 2023-509845-10-00: A multicenter, open-label, randomized study with single-arm extension period to assess the pharmacokinetics, safety and efficacy of macitentan versus standard of care in children with pulmonary arterial hypertension
Protocol code: AC-055-312
Sponsor: Actelion Pharmaceuticals Ltd. (Pharmaceutical company). Phase: Therapeutic confirmatory (Phase III). Countries: Portugal (ended), Hungary (ended), Spain (ended), Poland (ended).
Therapeutic area(s): Diseases [C] - Respiratory Tract Diseases [C08]
Gender: Female, Male. Age: 0-17 years. Enrolment: 19.
Status: Ended. Start date (EU): 2017-10-02. End date (EU): 2025-06-04. End date: 2025-11-27. Decision date: 2024-08-20. Results received: Yes. Last updated: 2025-05-13.
Decision dates by country: PT: 2024-08-21, HU: 2024-08-27, PL: 2024-08-30, ES: 2024-08-20

Condition(s): Pediatric pulmonary arterial hypertension
Product: JNJ-67896062, JNJ-67896062

Primary endpoint: "In subjects ≥ 2 years of age in the macitentan arm: • Trough (pre-dose) plasma concentrations of macitentan and its active metabolite(ACT-132 577) at Week 12 (steady-state) ", "In subjects less than 2 years of age on macitentan: • Trough concentrations of macitentan and its active metabolite (ACT132577) at Week 4 (steady-state)"
Endpoint(s): "The secondary endpoints are listed below: • Time to first CEC-confirmed hospitalization for PAH occurring between randomization/Visit 2 and end of core period (EOCP). • Time to CEC-confirmed death due to PAH occurring between randomization/Visit 2 and end of core period (EOCP).", • Time to death (all causes) occurring between randomization/Visit 2 and Study Closure., "Following secondary endpoints are analyzed up to end of randomized macitentan or SoC + 7 days. Baseline is the last non-missing value observed before or on the day of randomization/ Visit 2 • WHO FC status (I or II vs III or IV) at Week 24. • Percent of Baseline plasma NT-proBNP at Week 24. • Change from Baseline to Week 48 in in mean daily time spent in moderate to vigorous physical activity as measured by accelerometry.", "• Change from Baseline to Week 24 in tricuspid annular plane systolic excursion (TAPSE), and left ventricular eccentricity index measured by echocardiography (centrally assessed). • Change from Baseline to Week 24 in Quality of Life as measured by the PedsQLTM 4.0 Generic Core Scales Short Form (SF15)1. "

Source: https://euclinicaltrials.eu/ctis-public/view/2023-509845-10-00